EU clinical trial 2024-513591-18-00: A randomized, double-blind, parallel-group, active-controlled comparative study to evaluate the efficacy, safety, pharmacokinetics, and immunogenicity of LY06006 compared with EU-Prolia in postmenopausal women with osteoporosis
Protocol code: LY06006/MRCT-301
Sponsor: Shandong Boan Biotechnology Co. Ltd. (Pharmaceutical company). Phase: Therapeutic confirmatory (Phase III). Countries: Czechia (ended), Bulgaria (ended), Poland (ended).
Therapeutic area(s): Phenomena and Processes [G] - Musculoskeletal and Neural Physiological Phenomena [G11]
Gender: Female. Age: 18-64 years, 65+ years. Enrolment: 460.
Status: Ended. Start date (EU): 2023-04-26. End date (EU): 2025-06-13. End date: 2025-06-17. Decision date: 2024-11-14. Results received: No. Last updated: 2025-03-27.
Decision dates by country: PL: 2024-11-18, CZ: 2024-11-14, BG: 2024-11-14

Condition(s): Postmenopausal osteoporosis
Product: Prolia 60 mg solution for injection in pre-filled syringe, LY06006

Primary endpoint: Information is not publicly available
Endpoint(s): %CfB in lumbar spine BMD at Month 6, %CfB in total hip BMD at Months 6 and 12, %CfB in femoral neck BMD at Months 6 and 12, %CfB in sCTX at Months 0.5, 1, 2, 3, 6, 9, and 12, %CfB in sP1NP at Months 1, 6, and 12, AEs, including SAEs, Vital signs, Physical and dental examination, Clinical laboratory tests (hematology, clinical chemistry, and urinalysis), 12-lead ECG, Injection site reaction assessment, Serum drug concentrations at baseline and at Months 0.5, 1, 2, 3, 6, 9, and 12, Incidence of ADAs at baseline and at Months 0.5, 1, 2, 3, 6, 9, and 12, Incidence of NAbs at baseline and at Months 0.5, 1, 2, 3, 6, 9, and 12, %CfB (Month 12) in sCTX at Month 18, %CfB (Month 12) in sP1NP at Month 18, Serum drug concentrations at baseline (Month 12) and Months 15 and 18, Incidence of ADAs at baseline (Month 12), and Months 15 and 18, Incidence of NAbs at baseline (Month 12) and at Months 15 and 18

Source: https://euclinicaltrials.eu/ctis-public/view/2024-513591-18-00